EU clinical trial 2023-509572-42-00: A Phase 1b/2 Open-Label, Multicenter Study of RMC-6236 in Combination with Pembrolizumab with or without Chemotherapy, in Patients with RAS‑Mutated Non-Small Cell Lung Cancer (NSCLC) – Subprotocol B
Protocol code: RMC-LUNG-101B
Sponsor: Revolution Medicines Inc. (Pharmaceutical company). Phase: Human Pharmacology (Phase I)- Other. Countries: Spain (ongoing, recruiting), France (ongoing, recruiting), Italy (ongoing, recruiting), Netherlands (ongoing, recruiting), Germany (ongoing, recruiting).
Therapeutic area(s): Diseases [C] - Respiratory Tract Diseases [C08]
Gender: Female, Male. Age: 18-64 years, 65+ years. Enrolment: 180.
Status: Ongoing, recruiting. Start date (EU): 2024-07-17. Decision date: 2024-06-25. Results received: No. Last updated: 2026-01-13.
Decision dates by country: NL: 2024-08-14, ES: 2024-07-01, IT: 2024-06-26, DE: 2024-08-06, FR: 2024-07-01

Condition(s): Lung Cancer
Product: Pemetrexed Synthon 25 mg/ml, concentraat voor oplossing voor infusie, DARAXONRASIB (RMC-6236), Pemetrexed Fresenius Kabi 100 mg powder for concentrate for solution for infusion, Cisplatin Hikma 1 mg/ml Konzentrat zur Herstellung einer Infusionslösung, Carboplatin Kabi 10 mg/ml Konzentrat zur Herstellung einer Infusionslösung, DARAXONRASIB (RMC-6236), Cisplatinum Accord, 1 mg/ml, koncentrat do sporządzania roztworu do infuzji., CISPLATIN-EBEWE, 1 MG/ML, KONCENTRAT DO SPORZĄDZANIA ROZTWORU DO INFUZJI, Pemetrexed Fresenius Kabi 100 mg powder for concentrate for solution for infusion, KEYTRUDA 25 mg/mL concentrate for solution for infusion, Pemetrexed Fresenius Kabi 100 mg powder for concentrate for solution for infusion, Pemetrexed Fresenius Kabi 100 mg powder for concentrate for solution for infusion, KEYTRUDA 25 mg/mL concentrate for solution for infusion, DARAXONRASIB (RMC-6236), Pemetrexed Fresenius Kabi 100 mg powder for concentrate for solution for infusion, Cisplatin Hikma 1 mg/ml Konzentrat zur Herstellung einer Infusionslösung, Cisplatinum Accord, 1 mg/ml, koncentrat do sporządzania roztworu do infuzji., CARBOPLATIN-EBEWE, 10 MG/ML, KONCENTRAT DO SPORZĄDZANIA ROZTWORU DO INFUZJI, KEYTRUDA 25 mg/mL concentrate for solution for infusion, CARBO-cell® 10 mg/ml Infusionslösung, Konzentrat zur Herstellung einer Infusionslösung, Pemetrexed STADA 25 mg/ml Konzentrat zur Herstellung einer Infusionslösung, Pemetrexed Fresenius Kabi 100 mg powder for concentrate for solution for infusion, Cisplatinum Accord, 1 mg/ml, koncentrat do sporządzania roztworu do infuzji., KEYTRUDA 25 mg/mL concentrate for solution for infusion, Cisplatinum Accord, 1 mg/ml, koncentrat do sporządzania roztworu do infuzji., Pemetrexed Fresenius Kabi 100 mg powder for concentrate for solution for infusion

Primary endpoint: • Incidence of DLTs (Part 1 and Part 2 Cohort 2 safety lead-in only), •Incidence of TEAEs, TRAEs, SAEs, and clinically significant changes in laboratory test values, ECGs, and vital signs
Endpoint(s): • Concentrations of RMC-6236 in plasma over time and PK parameters as applicable., • ORR and DOR per RECIST v1.1

Source: https://euclinicaltrials.eu/ctis-public/view/2023-509572-42-00